EU clinical trial 2024-513941-35-00: A randomized comparative phase II trial evaluating the capacity of the dual combination doravirine/raltegravir to maintain virological success in HIV-1 infected patients with an HIV-RNA plasma viremia below 50 copies/mL under a current antiretroviral regimen
Protocol code: CREPATS 10
Sponsor: Centre de Recherches et d’Etudes sur les Pathologies Infectieuses, Tropicales et le VIH/Sida (Health care). Phase: Phase I and Phase II (Integrated)- Other. Countries: Spain (authorised, recruitment pending), Italy (authorised, recruitment pending), France (authorised, recruitment pending).
Therapeutic area(s): Diseases [C] - Virus Diseases [C02]
Gender: Female, Male. Age: 18-64 years, 65+ years. Enrolment: 118.
Status: Authorised, recruitment pending. Decision date: 2024-12-13. Results received: No. Last updated: 2025-01-29.
Decision dates by country: FR: 2025-01-29, IT: 2025-01-28, ES: 2024-12-13

Condition(s): HIV Disease
Product: Pifeltro 100 mg film-coated tablets, Raltegravir 600 mg film-coated tablets

Primary endpoint: The proportion of patients with virological failure before or at week 48. Protocol virological failure is defined as two pVL>50 copies/mL two weeks apart.
Endpoint(s): Proportion of patients maintaining viral suppression (pVL <50 copies/mL, Snapshot approach, Evolution of CD4 and CD8 T-cells, and CD4/CD8 ratio, Proportion of patients with virological blips (HIV-RNA pVL>50 copies/mL followed by a second measurement <50 copies/mL), Resistance profile in case of protocol defined virological failure (PDVF), Proportion of patients with acquired resistance mutation among those with PDVF, Frequency of grade 3 and 4 events, Quality of life assessed by self-questionnaire at screening, D0, W24, W48, W72, W96, Observance assessed by self-questionnaire at D0, W24, W48, W96, To assess HIV-RNA viral load and Cmin (Minimal Drug Concentration) of doravirine/raltegravir D0, W24 and W48 visits for patients in “Immediate switch” arm and D0, W72 and W96 visits for patients in “delayed switch” arm in human male genital compartment (30 patients included in the french centers), Evaluate the maintenance of HIV viral suppression as well as changes in neuronal injury and inflammatory markers in cerebrospinal fluid (CSF) at D0 and W48 (CSF sub-study, 15 patients included in the Spanish centers)

Source: https://euclinicaltrials.eu/ctis-public/view/2024-513941-35-00